EU clinical trial 2024-518901-16-00: BACILLE CALMETTE-GUÉRIN (BCG) VACCINE IN RADIOLOGICALLY ISOLATED SYNDROME (RIS)
Protocol code: BCG-RIS-01
Sponsor: Fondazione Italiana Sclerosi Multipla Ente Del Terzo Settore/et S (Patient organisation/association). Phase: Therapeutic exploratory (Phase II). Countries: Italy (ongoing, recruiting).
Therapeutic area(s): Diseases [C] - Nervous System Diseases [C10]
Gender: Female, Male. Age: 18-64 years. Enrolment: 100.
Status: Ongoing, recruiting. Start date (EU): 2019-07-29. Decision date: 2024-11-27. Results received: No. Last updated: 2024-11-27.

Condition(s): RIS (Radiologically Isolated Syndrome)
Product: Sodio cloruro S.A.L.F. 0,9% solvente per uso parenterale., BCG 10 Anti-Tuberculosis Vaccine, Powder and solvent for suspension for intradermal injection Vaccinum tuberculosis (BCG) cryodesiccatum

Primary endpoint: The primary endpoint of the study will be the cumulative number of CUAL on MRI scans over 1 year.
Endpoint(s): Time to first clinical event within the 3-year period., Exploraty endpoints: - Number of cortical lesions - Percentage of Brain Volume Changes (PBVC) - Changes in volume of cortex and White matter - Magnetization transfer ratio (MTr) in lesions - MTr in normal-looking brain, Safety / tolerability endpoints: Adverse events occurring during the study and laboratory tests

Source: https://euclinicaltrials.eu/ctis-public/view/2024-518901-16-00